EU clinical trial 2022-500505-41-00: (21751) First-in-human single dose escalation study to investigate the safety, tolerability, pharmacokinetics and pharmacodynamics of BAY 3018250 in healthy men in a randomized, placebo-controlled, single-blind, group-comparison design
Protocol code: 21751
Sponsor: Bayer AG (Pharmaceutical company). Phase: Human Pharmacology (Phase I)- First administration to humans. Countries: Germany (ended).
Therapeutic area(s): Diseases [C] - Cardiovascular Diseases [C14]
Gender: Male. Age: 18-64 years. Enrolment: 40.
Status: Ended. Start date (EU): 2022-11-08. End date (EU): 2023-05-12. Decision date: 2022-10-11. Results received: Yes. Last updated: 2022-12-20.

Condition(s): Acute ischemic stroke
Product: BAY 3018250, Placebo equals test product, except active substance

Primary endpoint: Number of participants who experienced treatment-emergent adverse events(TEAEs) and drug-related TEAEs after administration of BAY3018250
Endpoint(s): Cmax and Cmax/D of BAY3018250, AUC and AUC/D of BAY3018250 (if AUC cannot be determined reliably in all participants, AUC(0-t) will be used instead)

Source: https://euclinicaltrials.eu/ctis-public/view/2022-500505-41-00